EU clinical trial 2024-511501-37-00: A study to test how different doses of BI 1703880 in combination with ezabenlimab are tolerated in people with different types of advanced cancer (solid tumours)
Protocol code: 1480-0001
Sponsor: Boehringer Ingelheim International GmbH (Pharmaceutical company). Phase: Human Pharmacology (Phase I)- First administration to humans. Countries: Spain (ongoing, recruiting).
Therapeutic area(s): Diseases [C] - Neoplasms [C04]
Gender: Female, Male. Age: 18-64 years, 65+ years. Enrolment: 26.
Status: Ongoing, recruiting. Start date (EU): 2025-10-31. Decision date: 2024-07-05. Results received: No. Last updated: 2026-01-30.

Condition(s): Advanced solid tumours

Source: https://euclinicaltrials.eu/ctis-public/view/2024-511501-37-00